EU clinical trial 2024-518471-63-00: A Study to Investigate the Response of Participants With Type 2 Diabetes Mellitus on Once-Weekly Retatrutide to Hypoglycemia
Protocol code: J1I-MC-GZQF
Sponsor: Eli Lilly & Co. (Pharmaceutical company). Phase: Human Pharmacology (Phase I)- Other. Countries: Austria (ended).
Therapeutic area(s): Phenomena and Processes [G] - Metabolism [G03]
Gender: Female, Male. Age: 18-64 years. Enrolment: 78.
Status: Ended. Start date (EU): 2025-06-03. End date (EU): 2026-05-04. End date: 2026-05-05. Decision date: 2025-05-13. Results received: No. Last updated: 2025-11-17.

Condition(s): Type 2 Diabetes Mellitus

Source: https://euclinicaltrials.eu/ctis-public/view/2024-518471-63-00